EU clinical trial 2024-514155-15-00: M9466 in Combination with Topoisomerase 1 Inhibitors-based Regimens in Advanced Solid Tumors and Colorectal Cancer (DDRiver 511)
Protocol code: MS202650_0001
Sponsor: Merck Healthcare KGaA (Pharmaceutical company). Phase: Human Pharmacology (Phase I)- Other. Countries: Spain (ended).
Therapeutic area(s): Diseases [C] - Neoplasms [C04]
Gender: Female, Male. Age: 18-64 years, 65+ years. Enrolment: 14.
Status: Ended. Start date (EU): 2025-01-08. End date (EU): 2025-12-02. End date: 2025-12-03. Decision date: 2024-10-21. Results received: No. Last updated: 2025-11-11.

Condition(s): Advanced solid tumors and colorectal cancer

Source: https://euclinicaltrials.eu/ctis-public/view/2024-514155-15-00